EU clinical trial 2025-522012-16-00: Master Protocol: A Phase 1b / 2, Multicenter, Multi Arm Study of Evorpacept in Combination with Anti-cancer Therapies in Advanced / Metastatic Malignancies (ASPEN-09) Substudy Protocol: A Single-arm Phase 2 Multicenter Study of Evorpacept in Combination with Trastuzumab and Chemotherapy in Participants with Metastatic HER2-Positive Breast Cancer (ASPEN-09-03)
Protocol code: AT148009
Sponsor: Alx Oncology Holdings Inc. (Pharmaceutical company). Phase: Therapeutic exploratory (Phase II). Countries: Spain (ongoing, recruiting), Italy (ongoing, recruiting), France (ongoing, recruiting).
Therapeutic area(s): Diseases [C] - Neoplasms [C04]
Gender: Female, Male. Age: 18-64 years, 65+ years. Enrolment: 54.
Status: Ongoing, recruiting. Start date (EU): 2026-03-13. Decision date: 2026-01-23. Results received: No. Last updated: 2026-08-04.
Decision dates by country: IT: 2026-01-23, ES: 2026-01-23, FR: 2026-01-23

Condition(s): Breast Cancer
Product: Herzuma 150 mg powder for concentrate for solution for infusion, HALAVEN 0.44 mg/ml solution for injection, evorpacept, GEMZAR 1000 mg, poudre pour solution pour perfusion, Paclitaxel 6 mg/mL concentrate for solution for infusion, HALAVEN 0.44 mg/ml solution for injection, Xeloda 150 mg film-coated tablets, Vinorelbine 10 mg/ml concentrate for solution for infusion, Xeloda 500 mg film-coated tablets, Herceptin 150 mg powder for concentrate for solution for infusion, GEMZAR 200 mg, poudre pour solution pour perfusion

Primary endpoint: Overall response rate (ORR) using Response Evaluation Criteria in Solid Tumors version 1.1 (RECIST v1.1) based on Blinded Independent Central Review (BICR) assessment.
Endpoint(s): • ORR based on Investigator assessment., • Clinical Benefit Rate (CBR), Duration of Response (DoR), and Progression Free Survival (PFS), using RECIST v1.1 based on BICR and Investigator assessment, and Overall Survival (OS)., • Adverse Events (AEs) as characterized by type, frequency, severity (as graded by National Cancer Institute Common Terminology Criteria for Adverse Events version 5.0 [NCI CTCAE v5.0]), timing, seriousness, and relationship to study drug., • Laboratory abnormalities as characterized by type, frequency, severity (as graded by NCI CTCAE v5.0) and timing., • PK parameters of evorpacept such as maximum concentration (Cmax), time at maximum concentration (Tmax), area under the concentration-time curve (AUC), clearance (CL), and terminal elimination half-life (t1/2) as data permit., • Presence of human serum anti-drug antibodies (ADAs) (anti-evorpacept antibodies).

Source: https://euclinicaltrials.eu/ctis-public/view/2025-522012-16-00